EU clinical trial 2025-521735-36-00: A single-arm, multicenter, open-label, Phase I/II trial of Allo-QuadCAR01-T, an allogeneic CAR-T-cell therapy targeting CD19 and CD20, for the treatment of relapsed or refractory B-cell malignancies
Protocol code: AVC-203-01
Sponsor: Avencell Therapeutics Inc. (Pharmaceutical company). Phase: Phase I and Phase II (Integrated)- First administration to humans. Countries: Germany (ongoing, recruiting).
Therapeutic area(s): Diseases [C] - Neoplasms [C04]
Gender: Female, Male. Age: 18-64 years, 65+ years. Enrolment: 60.
Status: Ongoing, recruiting. Start date (EU): 2025-12-15. Decision date: 2025-10-27. Results received: No. Last updated: 2026-03-25.

Condition(s): Relapsed/refractory B-cell non-Hodgkin lymphoma (R/R B-NHL) or chronic lymphocytic leukaemia (CLL)
Product: Allo-QuadCAR01-T

Primary endpoint: Phase Ia: Incidence of adverse events (AEs) defined as dose-limiting toxicity (DLTs), Phase Ib: Incidence, type, and severity of all AEs, treatment-emergent adverse events (TEAEs), treatment-related adverse events (TRAEs), and serious adverse events (SAEs), Phase II: Complete response rate (CRR) through and including the Week 13 assessment visit
Endpoint(s): Phase Ia: Incidence, type and severity of all AEs, TEAEs, TRAEs, and SAEs including DLTs; Define recommended dose(s) for Phase Ib, Phase Ia: CRR (including complete response with incomplete hematological recovery (CRi) in chronic lymphocytic leukemia (CLL)) through and including the Week 13 assessment; Duration of response (DOR), Phase Ia: PK parameters of CAR-T (peak expansion, area under the concentration-time curve (AUC), persistence), Phase Ia: MRD levels in responding patients, Phase Ia: Incidence of antidrug antibody (ADA)1 formation against anti-CD19/CD20 ECD and ADA2 formation against the RevCAR extracellular domain (ECD) of Allo-QuadCAR01-T, Phase Ia: Enumeration of host PB B-cell, T cell, and NK-cell numbers, Phase Ib: CRR through and including the Week 13 assessment, Phase Ib: • DOR on trial • Partial response rate (PRR) through and including the Week 13 assessment • Overall response rate (ORR) through and including the Week 13 assessment • Progression free survival (PFS) • Time to next treatment (TTNT) • Overall survival (OS), Phase Ib: PK parameters of CAR-T (peak expansion, AUC, persistence), Phase Ib: MRD levels in responding patients, Phase Ib: Incidence of ADA1 formation against anti-CD19/CD20 ECD and ADA2 formation against the RevCAR ECD of Allo-QuadCAR01-T, Phase Ib: Enumeration of host PB B-cell, T cell, and NK cell numbers, Phase II: Incidence, type, and severity of all AEs, TEAEs, TRAEs, and SAEs, Phase II: • DOR • PRR through and including the Week 13 assessment visit • ORR through and including the Week 13 assessment visit • PFS • TTNT • OS, Phase II: PK parameters of CAR-T (peak expansion, AUC, persistence), Phase II: MRD levels in responding patients, Phase II: Incidence of ADA1 formation against anti-CD19/CD20 ECD and ADA2 formation against the RevCAR ECD of Allo-QuadCAR01-T, Phase II: Enumeration of host PB B-cell, T cell, and NK cell numbers

Source: https://euclinicaltrials.eu/ctis-public/view/2025-521735-36-00